EU clinical trial 2025-522862-58-00: A Phase 3, Multi-center, Randomized, Open-Label Clinical Study of Tislelizumab Administered as Subcutaneous Injection Versus Intravenous Infusion Plus Chemotherapy as First-Line Treatment in Patients With Locally Advanced Unresectable or Metastatic Gastric or Gastroesophageal Junction Adenocarcinoma
Protocol code: BGB-A317-316
Sponsor: BeOne Medicines AG (Pharmaceutical company). Phase: Therapeutic confirmatory (Phase III). Countries: Spain (ongoing, recruiting), France (ongoing, recruiting), Austria (ongoing, recruiting), Italy (ongoing, recruiting), Poland (authorised, recruitment pending), Czechia (ongoing, recruiting).
Therapeutic area(s): Diseases [C] - Neoplasms [C04]; Diseases [C] - Digestive System Diseases [C06]; Diseases [C] - Pathological Conditions, Signs and Symptoms [C23]
Gender: Female, Male. Age: 18-64 years, 65+ years. Enrolment: 63.
Start date (EU): 2026-01-09. Decision date: 2025-11-10. Results received: No. Last updated: 2026-07-27.
Decision dates by country: AT: 2025-11-17, IT: 2025-11-11, CZ: 2025-11-10, PL: 2025-11-15, ES: 2025-11-19, FR: 2025-11-17

Condition(s): Locally advanced unresectable or metastatic gastric or gastroesophageal junction adenocarcinoma
Product: Tevimbra 100 mg concentrate for solution for infusion, Tislelizumab 300 mg solution for injection

Primary endpoint: Model-predicted trough serum concentration (Ctrough) at steady-state (predose C5D1) and model-predicted AUC0-21d of Cycle 1
Endpoint(s): Overall response rate (ORR), progression-free survival (PFS), duration of response (DOR), and disease control rate (DCR) each assessed by investigator per RECIST v1.1, and overall survival (OS), Adverse events (AE) and serious adverse events (SAE) as characterized by type, frequency, severity (NCI-CTCAE v5.0), timing, seriousness, and relationship to study treatment, Model-predicted and observed Cycle 1 Ctrough, observed Cycle 1 AUC, and model-predicted AUC at steady-state (AUCss), Percentage of patients with antidrug antibodies (ADAs) to tislelizumab after subcutaneous (SC) or intravenous (IV) administration

Source: https://euclinicaltrials.eu/ctis-public/view/2025-522862-58-00